EU clinical trial 2022-502775-29-01: An open-label, randomized phase III trial comparing local radiotherapy alone or combined with Obinutuzumab in early stage Follicular Lymphoma: the GAZEBO Trial from the Fondazione Italiana Linfomi
Sponsor: Fondazione Italiana Linfomi Onlus (Patient organisation/association). Phase: Therapeutic confirmatory (Phase III). Countries: Italy (ongoing, recruiting).
Therapeutic area(s): Diseases [C] - Hemic and Lymphatic Diseases [C15]
Gender: Female, Male. Age: 18-64 years, 65+ years. Enrolment: 190.
Status: Ongoing, recruiting. Start date (EU): 2023-12-14. Decision date: 2023-10-16. Results received: No. Last updated: 2026-06-25.

Condition(s): Early stage Follicular Lymphoma
Product: Gazyvaro 1,000 mg concentrate for solution for infusion.

Primary endpoint: Progression-free survival (PFS) in the two arms.
Endpoint(s): 1. Complete response (CR) rate according to the international criteria (Cheson 2014), 2. Overall Response Rate (ORR) at every treatment phase, 3. Disease Free Survival (DFS), 4. Event Free Survival (EFS), 5. Molecular response reported as MRD negativity at end of treatment for positive patients at baseline by arms, 6. Rate of Adverse Events (named according to the latest version NCI CTCAE) by arms, 7. Prognostic and predictive impact on PFS in presence or absence of t(14;18) rearrangement by FISH; expression of selected tumour and microenvironment-related genes, 8. Prognostic role of conventional MRD and of MRD on plasmatic circulating tumour deoxyribonucleic acid (ctDNA) at different time points for PFS and relapse, 9. Prognostic and predictive value of different threshold of the metabolic response expressed as quantitative PET indexes (QPI) at baseline (PET-0), i.e. SUVmax, MTV and TLG, 10. Prognostic and predictive role of liquid biopsy (i.e. lymphoma mutations on plasmatic ctDNA) at different time points on PFS and relapse, 11. Prognostic and predictive value of radiomic analysis, assessed on both CT and PET images (multimodal analysis) on PFS, 12. Correlation of MRD results with the radiomics results and clinical outcomes, 13. Association between genotype at diagnosis and at relapse, 14. Association between liquid biopsy in anticipating clonal evolution.

Source: https://euclinicaltrials.eu/ctis-public/view/2022-502775-29-01